EU clinical trial 2025-520982-39-00: AALL2131/EsPhALL2022, An International Pilot Study of Chemotherapy and Tyrosine Kinase Inhibitor with Blinatumomab in Patients with Newly Diagnosed Philadelphia Chromosome Positive or ABL-class Philadelphia Chromosome-Like B-cell Acute Lymphoblastic Leukemia
Sponsor: Universita Degli Studi Di Milano Bicocca (Educational Institution). Phase: Therapeutic confirmatory (Phase III). Countries: France (ongoing, recruiting), Lithuania (authorised, recruitment pending), Norway (authorised, recruitment pending), Finland (authorised, recruitment pending), Spain (authorised, recruitment pending), Italy (ongoing, recruiting), Czechia (authorised, recruitment pending), Germany (authorised, recruitment pending), Hungary (authorised, recruitment pending), Slovakia (authorised, recruitment pending), Denmark (authorised, recruitment pending), Austria (authorised, recruitment pending), Netherlands (authorised, recruitment pending).
Therapeutic area(s): Diseases [C] - Neoplasms [C04]; Diseases [C] - Hemic and Lymphatic Diseases [C15]
Gender: Female, Male. Age: 0-17 years, 18-64 years. Enrolment: 87.
Start date (EU): 2025-12-09. Decision date: 2025-12-09. Results received: No. Last updated: 2026-05-08.
Decision dates by country: AT: 2025-12-14, DE: 2025-12-11, DK: 2025-12-10, FR: 2025-12-15, HU: 2025-12-15, LT: 2025-12-10, ES: 2025-12-12, NO: 2025-12-11, SK: 2025-12-11, IT: 2025-12-09, NL: 2025-12-11, FI: 2025-12-10, CZ: 2025-12-10

Condition(s): Philadelphia Chromosome Positive or ABL-class Philadelphia Chromosome-Like B-cell Acute Lymphoblastic Leukemia, Philadelphia Chromosome Positive or ABL-class Philadelphia Chromosome-Like B-cell Acute Lymphoblastic Leukemia, Philadelphia Chromosome Positive or ABL-class Philadelphia Chromosome-Like B-cell Acute Lymphoblastic Leukemia, Philadelphia Chromosome Positive or ABL-class Philadelphia Chromosome-Like B-cell Acute Lymphoblastic Leukemia, Philadelphia Chromosome Positive or ABL-class Philadelphia Chromosome-Like B-cell Acute Lymphoblastic Leukemia
Product: BLINCYTO 38.5 micrograms powder for concentrate and solution for solution for infusion.

Primary endpoint: To estimate the 3-year event free survival (EFS) of children, adolescents, and young adults <25 years old with newly-diagnosed Ph+ B-ALL who are treated with a modified Berlin-Frankfurt-Münster (BFM) chemotherapy backbone that incorporates three cycles of blinatumomab without traditional consolidation chemotherapy in combination with continuous dasatinib, To estimate the 3-year EFS of children, adolescents, and young adults <25 years old with newly-diagnosed ABL-class Ph-like B-ALL who are treated with a modified BFM chemotherapy backbone that incorporates three cycles of blinatumomab without traditional consolidation chemotherapy in combination with continuous imatinib for those with PDGFRB fusions or dasatinib for those without PDGFRB fusions, To describe the safety and toxicity profile (infections, mucositis, neurotoxicity, cytokine release syndrome, hypogammaglobulinemia, therapy delays > 14 days, and treatment-related mortality) for patients with Ph+ or ABL-class Ph-like B-ALL treated on this novel chemo-immunotherapy backbone with continuous TKI.
Endpoint(s): To estimate the 3-year overall survival (OS) of patients with Ph+ and ABL-class Ph-like B-ALL, respectively., To estimate the 3-year EFS, disease-free survival (DFS), cumulative incidence rates (CIR) of relapse, and treatment related mortality (TRM), and OS of patients with ABL-class Ph-like B-ALL stratified by their underlying ABL-class fusion subtypes, To describe rates of EOC/TP2 MRD negativity defined as <1x10-4 or <0.01% for patients with ABL-class Ph-like B-ALL collectively and based on their ABL-class fusion subtypes.

Source: https://euclinicaltrials.eu/ctis-public/view/2025-520982-39-00